EU clinical trial 2024-517408-12-00: Double-blind Placebo-Controlled Randomized Clinical Trial of Mineralocorticoid Receptor Blockade With Eplerenone After Renal Transplantation : Effect on Graft Function at 3 Months. EPURE TRANSPLANT
Sponsor: CHRU De Nancy (Hospital/Clinic/Other health care facility). Phase: Therapeutic confirmatory (Phase III). Countries: France (ongoing, recruiting).
Therapeutic area(s): Diseases [C] - Cardiovascular Diseases [C14]
Gender: Female, Male. Age: 18-64 years, 65+ years. Enrolment: 132.
Status: Ongoing, recruiting. Start date (EU): 2024-11-28. Decision date: 2024-11-28. Results received: No. Last updated: 2024-11-28.

Condition(s): Patient in end-stage renal disease candidate for a kidney transplant
Product: OMNIPAQUE 300 mg d'I/ml, solution injectable, Gélules de lactose monohydraté additionné de carmin de cochenille, INSPRA 50 mg, comprimé pelliculé

Primary endpoint: Iohexol clearance at 3 months
Endpoint(s): Proportion of dialysis dependency at 3 months, Proportion of patients presenting a delayed graft function at 7 days post transplantation, 24-hour proteinuria and 24-hour microalbuminuria at 3 months, Occurrence of hyperkalemia > 6 mmol/l at 7 days post transplantation, Length of initial hospital stay, Proportion of patients alive and glomerular filtration rate at 3 months 1 year, 3 years, 10 years post transplantation, Proportion of patients with biopsy-proven acute rejection at 3 months post tranplantation

Source: https://euclinicaltrials.eu/ctis-public/view/2024-517408-12-00